EU clinical trial 2022-502916-35-01: A Phase II, Open-label, Platform Study, to Evaluate Immunotherapy-based Combinations in Participants With Advanced Non-Small Cell Lung Cancer
Protocol code: EDGE-Lung
Sponsor: Gilead Sciences Inc. (Pharmaceutical company). Phase: Therapeutic exploratory (Phase II). Countries: France (ongoing, recruitment ended), Spain (ongoing, recruitment ended), Italy (ongoing, recruitment ended), Poland (ongoing, recruitment ended).
Therapeutic area(s): Diseases [C] - Neoplasms [C04]
Gender: Female, Male. Age: 18-64 years, 65+ years. Enrolment: 100.
Status: Ongoing, recruitment ended. Start date (EU): 2024-03-27. Decision date: 2023-11-24. Results received: No. Last updated: 2026-06-24.
Decision dates by country: IT: 2024-03-27, ES: 2024-03-14, FR: 2023-11-24, PL: 2024-03-18

Condition(s): Advanced Non-Small Cell Lung Cancer
Product: Carboplatine Hikma 450 mg/45 ml oplossing voor infusie, Paclitaxel Ribosepharm 6 mg/ml Konzentrat zur Herstellung einer Infusionslösung, CARBO-cell® 10 mg/ml Infusionslösung, Konzentrat zur Herstellung einer Infusionslösung, Pemetrexed Fresenius Kabi 25 mg/ml concentrate for solution for infusion, Docetaxel Hikma 160 mg/8 ml Konzentrat zur Herstellung einer Infusionslösung, Carboplatine Hikma 450 mg/45 ml Infusionslösung, Cisplatin NeoCorp 1 mg/ml - Konzentrat zur Herstellung einer Infusionslösung, Pemetrexed NeoCorp 25 mg/ml Konzentrat zur Herstellung einer Infusionslösung, Pemetrexed Hexal 25 mg/ml infuusiokonsentraatti, liuosta varten, Cisplatine 1 mg/ml PCH, concentraat voor oplossing voor infusie, Zimberelimab, Abraxane 5 mg/ml powder for dispersion for infusion., CISPLATINE TEVA 1 mg/ml KONZENTRAT ZUR HERSTELLUNG EINER INFUSIONSLÖSUNG, Carboplatin Hikma 10 mg/ml Konzentrat zur Herstellung einer Infusionslösung, Cisplatine Teva 1 mg/ml concentraat voor oplossing voor infusie, DOMVANALIMAB, Pemetrexed Ribosepharm 25 mg/ml Konzentrat zur Herstellung einer Infusionslösung, Carboplatine Hikma 450 mg/45 ml solution pour perfusion, Paclitaxel AqVida 6 mg/ml Konzentrat zur Herstellung einer Infusionslösung, Pemetrexed STADA 25 mg/ml Konzentrat zur Herstellung einer Infusionslösung, Docetaxel AqVida 20 mg/ml Konzentrat zur Herstellung einer Infusionslösung, Cisplatine Teva 1 mg/ml solution à diluer pour perfusion., Quemliclustat

Primary endpoint: ORR is defined as the percentage of participants who have achieved complete response (CR) or partial response (PR) as measured by Response Evaluation Criteria in Solid Tumors Version 1.1 (RECIST v1.1) and assessed by the investigator, The incidence and severity of adverse events (AEs) and serious adverse events (SAEs)
Endpoint(s): OS, PFS, Disease control rate (DCR), Duration of response (DoR), Plasma or serum concentration of investigational study treatments and estimated PK parameters, Percentage of biologic treatment-emergent antidrug antibody (ADA)-positive participants and ADA-negative participants

Source: https://euclinicaltrials.eu/ctis-public/view/2022-502916-35-01